EU clinical trial 2023-503969-36-01: Safety, Tolerability and Efficacy of NPI-001 (AT-001) in Patients with Hereditary Cystatin C Amyloid Angiopathy (HCCAA)
Protocol code: 2023-503969-36-01
Sponsor: Arctic Therapeutics hf. (Pharmaceutical company). Phase: Therapeutic exploratory (Phase II). Countries: Iceland (ongoing, recruitment ended).
Therapeutic area(s): Diseases [C] - Congenital, Hereditary, and Neonatal Diseases and Abnormalities [C16]
Gender: Female, Male. Age: 0-17 years, 18-64 years, 65+ years. Enrolment: 25.
Status: Ongoing, recruitment ended. Start date (EU): 2024-03-26. Decision date: 2024-02-28. Results received: No. Last updated: 2026-04-20.

Condition(s): Hereditary Cystatin C Amyloid Angiopathy (HCCAA)

Primary endpoint: Safety • Treatment-Emergent Adverse Events and Serious Adverse Events, vital signs, ECG, physical and neurological examination, safety laboratory blood and urinalysis after a single dose of 250 mg and 750 mg of NACA (PK cohort), 12 months of treatment (main study) and after 24 months of treatment (OLE phase), Efficacy • Frequency of clinical cerebral bleedings events, defined as any bleed that causes stroke, hemorrhagic or ischemic after 12 months of treatment (main study) and after 24 months of treatment (OLE phase)
Endpoint(s): • Clinical Dementia Rating (DSR-2) Scale, • Deaths, • Levels of cystatin C/amyloid dimers/oligomiers/polymers vs monomers of same, • Levels of glutathione and GSSG/GSH ratios in plasma, • hCC levels in urine, • Plasma concentrations of NPI-001 PK parameters: Cmax, Tmax and AUC0-24h and T1/2 for single dose of 250mg or 750mg (and steady state for subjects participating in the main study), • Skin deposition of cystatin C/amyloid protein complex, including monomer vs dimer (and other high-molecular versions of same) ratios, together with skin collagen deposition and cell surface marker activation (vimentin, SMAD/WNT-1) which are correlated, • (1) Clinical impact in terms on speech, paralysis and how quickly symptoms reverse (2) CT scan to assess size, distribution and resolution of hemorrhage in the brain

Source: https://euclinicaltrials.eu/ctis-public/view/2023-503969-36-01